EU clinical trial 2024-513692-41-00: A trial to learn how saruparib works and how safe it is in the bodies of adults with advanced solid tumors
Protocol code: D9723C00002
Sponsor: AstraZeneca AB (Pharmaceutical company). Phase: Human Pharmacology (Phase I)- Other. Countries: Bulgaria (ended), Romania (ongoing, recruitment ended).
Therapeutic area(s): Diseases [C] - Neoplasms [C04]
Gender: Female, Male. Age: 18-64 years, 65+ years. Enrolment: 33.
Start date (EU): 2025-06-11. Decision date: 2025-05-22. Results received: No. Last updated: 2026-07-22.
Decision dates by country: BG: 2025-05-22, RO: 2025-05-26

Condition(s): advanced solid malignancies

Source: https://euclinicaltrials.eu/ctis-public/view/2024-513692-41-00